EU clinical trial 2024-515215-21-00: A Single-arm, Open-label Phase 4 Study of Nirogacestat in Adult Premenopausal Females with Desmoid Tumors/Aggressive Fibromatosis (DT/AF)
Protocol code: NIR-DT-401
Sponsor: Springworks Therapeutics Inc. (Pharmaceutical company). Phase: Therapeutic use (Phase IV). Countries: Netherlands (ongoing, recruiting), Italy (ongoing, recruiting), Spain (ongoing, recruiting), Belgium (ongoing, recruiting), Germany (ongoing, recruiting).
Therapeutic area(s): Diseases [C] - Skin and Connective Tissue Diseases [C17]
Gender: Female. Age: 18-64 years. Enrolment: 47.
Status: Ongoing, recruiting. Start date (EU): 2025-10-24. Decision date: 2025-09-15. Results received: No. Last updated: 2026-03-25.
Decision dates by country: DE: 2025-09-16, ES: 2025-09-24, IT: 2025-09-26, NL: 2025-09-16, BE: 2025-09-15

Condition(s): DESMOID TUMOURS/AGGRESSIVE FIBROMATOSIS (DT/AF)
Product: Nirogacestat, Nirogacestat

Primary endpoint: Ovarian function recovery rate of OT TEAEs. Ovarian function recovery is defined as achieving the resumption of ≥2 consecutive menstrual periods and an follicle stimulating hormone (FSH) level <30 mIU/mL with concomitant estradiol <80 pg/mL, OR resumption of ≥2 consecutive menstrual periods and anti-mullerian hormone (AMH) level within normal range adjusted for age and pretreatment baseline, OR a positive serum beta-human chorionic gonadotropin (β-HCG) pregnancy test.
Endpoint(s): 1.Incidence of OT TEAEs. OT is defined as new onset amenorrhea lasting ≥3 consecutive menstrual periods, FSH level ≥30 mIU/mL, AND a negative β-HCG pregnancy test., 2.Time to ovarian function recovery in participants with a TEAE of OT., 3.Safety endpoints will include incidence of TEAEs, changes in laboratory parameters including hormones, vital signs, and physical examination findings. Tolerability will be assessed according to toxicities graded by National Cancer Institute (NCI) Common Terminology Criteria for Adverse Events (CTCAE) v5.0.

Source: https://euclinicaltrials.eu/ctis-public/view/2024-515215-21-00